EU clinical trial 2024-515012-53-00: PARASTOP – Paracetamol with Strong Opioids. A randomized, double-blind, parallel-group non-inferiority phase III withdrawal trial of paracetamol versus placebo in conjunction with opioids for moderate to severe cancer-related pain
Protocol code: PARASTOP
Sponsor: Oslo University Hospital HF (Hospital/Clinic/Other health care facility). Phase: Therapeutic confirmatory (Phase III). Countries: Norway (ended).
Therapeutic area(s): Diseases [C] - Neoplasms [C04]
Gender: Female, Male. Age: 18-64 years, 65+ years. Enrolment: 179.
Status: Ended. Start date (EU): 2021-10-20. End date (EU): 2026-02-18. Decision date: 2024-10-29. Results received: No. Last updated: 2025-05-19.

Condition(s): Metastatic cancer disease
Product: Paracet 1 g tabletter, PLACEBO

Primary endpoint: Average pain intensity
Endpoint(s): Patient reported opioid related side effects, Patient reported opioid related side effects, Opioid consumption Day 8 (Total amount of scheduled and on demand opioids)

Source: https://euclinicaltrials.eu/ctis-public/view/2024-515012-53-00